EU clinical trial 2022-501974-21-00: A Phase 3, International, Multi-center, Randomized, Double-blind, Placebo-controlled Clinical Trial to Study the Efficacy, Immunogenicity, and Safety of the 9vHPV Vaccine, a Multivalent L1 Virus-like Particle Vaccine, in the prevention of oral persistent infection with HPV Types 16, 18, 31, 33, 45, 52, or 58 in adult males, 20 to 45 years of age
Protocol code: V503-049
Sponsor: Merck Sharp & Dohme LLC (Pharmaceutical company). Phase: Therapeutic confirmatory (Phase III). Countries: Germany (ongoing, recruitment ended), Czechia (ongoing, recruitment ended), Italy (ongoing, recruitment ended), France (ongoing, recruitment ended), Belgium (ongoing, recruitment ended), Spain (ongoing, recruitment ended).
Therapeutic area(s): Diseases [C] - Virus Diseases [C02]
Gender: Male. Age: 18-64 years. Enrolment: 1495.
Status: Ongoing, recruitment ended. Start date (EU): 2020-04-01. Decision date: 2022-11-29. Results received: No. Last updated: 2026-04-16.
Decision dates by country: IT: 2022-12-01, ES: 2022-12-01, DE: 2022-12-06, CZ: 2025-08-21, FR: 2022-11-29, BE: 2022-11-29

Condition(s): Prevention of oral persistent infection caused by any of the human papillomavirus types 16, 18, 31, 33, 45, 52, and 58
Product: Gardasil 9 suspension for injection Human Papillomavirus 9-valent Vaccine (Recombinant, adsorbed), Saline placebo for V503

Primary endpoint: Incidence of Human Papillomavirus (HPV)16/18/31/33/45/52/58-related 6-month Persistent Oral Infection
Endpoint(s): Incidence of HPV 6/11-related 6-month Persistent Oral Infection, Geometric Mean Titers to HPV Types 6, 11, 16, 18, 31, 33, 45, 52, and 58 Antibodies, Percentage of Participants Who Seroconvert to HPV Types 6, 11, 16, 18, 31, 33, 45, 52, and 58, Percentage of Participants with at Least 1 Solicited Injection-site Adverse Event (AE), Percentage of Participants with Elevated Temperature (Fever), Percentage of Participants Who Report at Least 1 Systemic AE, Percentage of Participants Who Experience at Least 1 Serious Adverse Event, Percentage of Participants Who Experience at Least 1 Serious Vaccine-related AE

Source: https://euclinicaltrials.eu/ctis-public/view/2022-501974-21-00